EU clinical trial 2024-513611-28-00: A Phase 2 Open-Label Study of Sacituzumab Govitecan (IMMU-132) in Subjects with Metastatic Solid Tumors
Protocol code: IMMU-132-11
Sponsor: Gilead Sciences Inc. (Pharmaceutical company). Phase: Therapeutic exploratory (Phase II). Countries: France (ongoing, recruitment ended), Spain (ended), Belgium (ended).
Therapeutic area(s): Diseases [C] - Neoplasms [C04]
Gender: Female, Male. Age: 18-64 years, 65+ years. Enrolment: 23.
Start date (EU): 2022-07-29. Decision date: 2024-07-12. Results received: No. Last updated: 2025-10-23.
Decision dates by country: BE: 2024-09-30, ES: 2024-09-23, FR: 2024-09-24

Condition(s): Metastatic Solid Tumors
Product: Trodelvy 200 mg powder for concentrate for solution for infusion

Primary endpoint: Objective response rate (ORR) according to RECIST 1.1 by Investigator's assessment.
Endpoint(s): ORR, DOR, CBR, and PFS according to RECIST 1.1 by BICR., DOR, CBR, and PFS, according to RECIST 1.1 by Investigator's assessment., Overall survival (OS)., Incidence of treatment-emergent adverse events (AEs) and clinical laboratory abnormalities., Serum concentrations of sacituzumab govitecan over time and incidence of anti-drug antibody (ADA) to sacituzumab govitecan.

Source: https://euclinicaltrials.eu/ctis-public/view/2024-513611-28-00